EU clinical trial 2025-520930-44-00: C5041053 - A PHASE 1 MULTIPLE-DOSE, OPEN-LABEL PHARMACOKINETIC STUDY OF ETRASIMOD IN HEALTHY LACTATING WOMEN
Protocol code: C5041053
Sponsor: Pfizer Inc. (Pharmaceutical company). Phase: Human Pharmacology (Phase I)- Other. Countries: Belgium (ongoing, recruiting).
Therapeutic area(s): Diseases [C] - Immune System Diseases [C20]
Gender: Female. Age: 18-64 years. Enrolment: 8.
Status: Ongoing, recruiting. Start date (EU): 2025-07-18. Decision date: 2025-05-07. Results received: No. Last updated: 2026-03-02.

Condition(s): Ulcerative Colitis and immune-mediated inflammatory disorders
Product: Etrasimod Arginine Blue

Primary endpoint: Breast milk etrasimod PK parameters: AUCtau, Cmax, Aebm, Aebm%, Tmax, and CLbm (if data permit).
Endpoint(s): Plasma etrasimod PK parameters: AUCtau, Cmax, Tmax, as data permits., MPAUCtau, TEAEs, clinical laboratory tests, vital signs, and ECGs, BWNID, BWNMD, and BWNIDPCM

Source: https://euclinicaltrials.eu/ctis-public/view/2025-520930-44-00